EU clinical trial 2022-502324-48-00: A Phase III double-blind placebo-controlled Randomised Trial of Aspirin on Recurrence and Survival in Colon Cancer Patients
Protocol code: NL38132.058.14
Sponsor: Leiden University Medical Center (Hospital/Clinic/Other health care facility). Phase: Therapeutic confirmatory (Phase III). Countries: Netherlands (ongoing, recruitment ended).
Therapeutic area(s): Diseases [C] - Neoplasms [C04]
Gender: Female, Male. Age: 18-64 years, 65+ years. Enrolment: 1588.
Status: Ongoing, recruitment ended. Start date (EU): 2014-08-05. Decision date: 2023-02-13. Results received: No. Last updated: 2023-02-13.

Condition(s): Patients with resected colon carcinoma
Product: ACETYLSALICYLIC ACID, PLACEBO

Primary endpoint: 5 year Overall Survival (5y-OS)
Endpoint(s): Disease Free Survival (DFS), Time to Treatment Failure (TTF)

Source: https://euclinicaltrials.eu/ctis-public/view/2022-502324-48-00